EU clinical trial 2024-519836-18-00: A Phase III, 52-week, prospective, randomized, double-blind, placebo-controlled, parallel-group, multi-center study, with a primary efficacy endpoint at 12 weeks, to determine the efficacy, safety, and tolerability of fixed doses of 15 mg bid and 30 mg bid of evenamide as add-on in patients with documented treatment-resistant schizophrenia, which is not adequately controlled by a stable therapeutic dose of the patient’s current antipsychotic medication(s).
Protocol code: NW-3509/023/III/2024
Sponsor: Newron Pharmaceuticals S.p.A. (Pharmaceutical company). Phase: Therapeutic confirmatory (Phase III). Countries: Hungary (authorised, recruitment pending), France (ongoing, recruiting), Bulgaria (ongoing, recruiting), Spain (ongoing, recruiting), Germany (authorised, recruitment pending), Croatia (authorised, recruitment pending), Italy (authorised, recruitment pending), Poland (ongoing, recruiting), Czechia (ongoing, recruiting).
Therapeutic area(s): Psychiatry and Psychology [F] - Mental Disorders [F03]
Gender: Female, Male. Age: 18-64 years, 65+ years. Enrolment: 135.
Start date (EU): 2025-12-16. Decision date: 2025-08-22. Results received: No. Last updated: 2026-07-15.
Decision dates by country: DE: 2025-11-13, PL: 2025-11-15, ES: 2025-08-26, IT: 2025-11-14, HU: 2025-08-26, FR: 2025-08-26, CZ: 2025-11-13, HR: 2025-11-17, BG: 2025-11-14

Condition(s): treatment-resistant schizophrenia (TRS)
Product: The placebo for NW-3509 drug product contains blended lactose monohydrate (29.50 mg/caps), microcrystalline cellulose (70.00 mg/caps), and magnesium stearate (0.50 mg/caps) filled into hard gelatin capsules.

Primary endpoint: Mean changes from baseline to endpoint (Week 12) on the PANSS total score will be compared between the evenamide 30 mg bid and placebo groups using a mixed-effects repeated measures model approach (MMRM), with treatment, region, visit, and treatmentby-visit interaction as fixed effects, and baseline value as covariate, will be used to analyze the mean change from baseline to Week 12 on the PANSS Total Score.
Endpoint(s): For the key secondary efficacy endpoint, the mean change from baseline on the CGI-S at endpoint (Week 12) will be compared between the evenamide 30 mg bid dose and placebo groups using the same MMRM approach used for the primary efficacy endpoint, with treatment, region, visit, and treatment-by-visit interaction as fixed effects, and baseline value as covariate

Source: https://euclinicaltrials.eu/ctis-public/view/2024-519836-18-00